EU clinical trial 2024-516483-29-00: A single-centre, single-dose, open label, non-randomized, parallel group, clinical pharmacology study of CHF 6001 in asthmatic adolescent patients and in asthmatic adult patients as control group
Protocol code: CLI-06001AC1-01
Sponsor: Chiesi Farmaceutici S.p.A. (Pharmaceutical company). Phase: Therapeutic exploratory (Phase II). Countries: Bulgaria (ended).
Therapeutic area(s): Diseases [C] - Respiratory Tract Diseases [C08]
Gender: Female, Male. Age: 0-17 years, 18-64 years, 65+ years. Enrolment: 50.
Status: Ended. Start date (EU): 2025-03-24. End date (EU): 2025-08-11. Decision date: 2025-01-23. Results received: Yes. Last updated: 2025-07-24.

Condition(s): Asthma
Product: CHF6001 DPI

Primary endpoint: CHF 6001 Cmax and area under the curve from 0 to the last quantifiable concentration (AUC 0-t).
Endpoint(s): PK variables will be evaluated after oral inhalation of CHF 6001 3200 μg with NEXThaler® device: • For CHF 6001: apparent systemic clearance (CL/F), time to maximum plasma concentration (tmax), area under the curve from 0 to infinity (AUC0-∞) and elimination half-life (t1/2); • For CHF 5956 and CHF 6095: tmax, AUC0-∞ and apparent terminal t1/2, Cmax and AUC0-t;, PD variables will be evaluated at different times from pre-dose until 10 hours post-dose: • Triplicate 12-lead ECG parameters: HR (including average 0 to 4 hours and 0 to 10 hours) and PR and QRS intervals and QTcF; • Systolic and diastolic BP., Determination of the safety profile will be based on the following assessments at different times from pre-dose until Visit 4 (follow-up visit): • AEs and adverse drug reactions (ADRs); • Standard laboratory parameters (haematology and blood chemistry; at screening and when clinically indicated); • HR from local 12-lead safety ECG (measured during visits); • BP (measured during visits).

Source: https://euclinicaltrials.eu/ctis-public/view/2024-516483-29-00